EU clinical trial 2023-506704-14-00: A Phase 2b, Multicenter, Randomized, Double-blind Induction, Placebo-Controlled, Dose-Ranging Study to Evaluate the Efficacy and Safety of Oral TAK-279 in Subjects with Moderately to Severely Active Crohn’s Disease
Protocol code: TAK-279-CD-2001
Sponsor: Takeda Development Center Americas Inc. (Pharmaceutical company). Phase: Therapeutic exploratory (Phase II). Countries: Netherlands (ongoing, recruiting), Hungary (ongoing, recruiting), Poland (ongoing, recruiting), Czechia (ongoing, recruiting), Greece (ongoing, recruiting), Slovakia (ongoing, recruiting), France (ongoing, recruiting), Belgium (ongoing, recruiting), Germany (ongoing, recruiting), Romania (ongoing, recruiting), Italy (ongoing, recruiting), Denmark (ongoing, recruiting), Norway (ongoing, recruiting), Bulgaria (ongoing, recruiting).
Therapeutic area(s): Diseases [C] - Digestive System Diseases [C06]
Gender: Female, Male. Age: 18-64 years, 65+ years. Enrolment: 162.
Status: Ongoing, recruiting. Start date (EU): 2024-09-04. Decision date: 2024-07-01. Results received: No. Last updated: 2026-07-07.
Decision dates by country: SK: 2024-07-03, DK: 2024-07-01, GR: 2024-07-04, NL: 2024-07-01, BE: 2024-07-02, IT: 2024-07-03, DE: 2024-07-03, BG: 2025-06-06, RO: 2024-07-08, CZ: 2024-07-03, FR: 2024-07-03, PL: 2024-07-02, NO: 2024-07-01, HU: 2024-07-04

Condition(s): Moderately to Severely Active Crohn's Disease
Product: ZASOCITINIB, TAK-279 placebo (same excipient as TAK-279), ZASOCITINIB

Primary endpoint: Endoscopic response at Week 12, assessed as proportion of subjects achieving decrease in Simple Endoscopic Score for Crohn’s Disease (SES‑CD) >50% from baseline (or for subjects with isolated ileal disease, SES-CD ≤4 or at least a 2‑point reduction from baseline) read centrally.
Endpoint(s): 01. Clinical remission at Week 12, assessed as proportion of subjects achieving CD Activity Index (CDAI)<150., 02. Clinical response at Week 12, assessed as proportion of subjects achieving reduction of CDAI from baseline of >100., 03. Endoscopic remission at Week 12, assessed as proportion of subjects achieving SES-CD ≤4 or ≤2 for ileal disease, no subscore >1., 04. Clinical remission in two patient-reported outcome items (PRO2) of the CDAI at Week 12, assessed as proportion of subjects with average daily liquid or very soft stool frequency (SF) score ≤2.8 and not worse than baseline and average daily abdominal pain (AP) score ≤1 and not worse than baseline., 05. Clinical response in PRO2 at Week 12, assessed as proportion of subjects with ≥30% decrease in average daily very soft or liquid stools and/ or ≥30% decrease in average AP from baseline., 06. Proportion of subjects with no bowel urgency as measured by the bowel urgency eDiary item at Week 12., 07. Disease-specific health-related quality of life (HRQoL) as measured by the Inflammatory Bowel Disease Questionnaire (IBDQ) at Week 12, assessed as proportion of subjects with total score ≥170., 08. Change from baseline in disease-specific HRQoL as measured by the IBDQ total score at Week 12., 09. Change from baseline in fatigue as measured by the Functional Assessment of Chronic Illness Therapy-Fatigue (FACIT-Fatigue) score at Week 12.

Source: https://euclinicaltrials.eu/ctis-public/view/2023-506704-14-00